EU clinical trial 2024-518159-52-02: Pharmacodynamics and safety of human recombinant luteinising hormone in hypogonadotropic hypogonadal men
Sponsor: Department Of Biomedical Metabolic And Neural Sciences (Educational Institution). Phase: Phase II and Phase III (Integrated). Countries: Italy (ended).
Therapeutic area(s): Diseases [C] - Hormonal diseases [C19]
Gender: Male. Age: 18-64 years. Enrolment: 1.
Status: Ended. End date (EU): 2025-04-04. Decision date: 2025-01-27. Results received: Yes. Last updated: 2025-01-27.

Condition(s): Hypogonadotropic hypogonadism
Product: LUTROPIN ALFA

Primary endpoint: Total testosterone serum levels

Source: https://euclinicaltrials.eu/ctis-public/view/2024-518159-52-02